EU clinical trial 2025-521684-12-00: A Phase 2a double blind, randomized, parallel arm, placebo-controlled trial to investigate the effects of two dose levels of CIT-013 on disease activity in patients with Hidradenitis Suppurativa (HS)
Protocol code: CITRYLL003
Sponsor: Citryll B.V. (Pharmaceutical company). Phase: Therapeutic exploratory (Phase II). Countries: Netherlands (ongoing, recruiting), Germany (ongoing, recruiting), Poland (ongoing, recruiting), Spain (ongoing, recruiting).
Therapeutic area(s): Diseases [C] - Skin and Connective Tissue Diseases [C17]
Gender: Female, Male. Age: 18-64 years, 65+ years. Enrolment: 64.
Status: Ongoing, recruiting. Start date (EU): 2026-01-13. Decision date: 2025-10-06. Results received: No. Last updated: 2026-05-15.
Decision dates by country: NL: 2025-10-06, DE: 2025-10-13, ES: 2025-10-10, PL: 2025-10-10

Condition(s): Hidradenitis Suppurativa
Product: Commercially available sodium chloride 0.9% solution in water, CIT-013

Primary endpoint: • Proportion of participants with HiSCR75 in pooled dose groups of CIT 013 (50 mg CIT-013 and 100 mg CIT-013) versus placebo at V11 (D85)
Endpoint(s): Incidence and severity of treatment-emergent (serious) adverse events ((S)AE)s, Change from baseline to Day 113 as measured by HiSCR50, HiSCR75 and HiSCR90 -, Change from baseline to Day 113 as measured by IHS4, Number of draining tunnels - change from baseline (V2) to all assessment timepoints (D29 [V5], D43 [V7], D85 [V11], D113 [V12]), Change in pain as reported by participant via numerical rating scale (NRS), Change in Quality of Life as assessed by participant by the DLQI, Change in Quality of Life as assessed by participant by the Hidradenitis Suppurativa Quality of Life (HiSQoL), Pharmacokinetic (PK) levels throughout the trial, per originally assigned treatment

Source: https://euclinicaltrials.eu/ctis-public/view/2025-521684-12-00